EU clinical trial 2024-513613-12-00: A randomized, double-blind, placebo-controlled study to evaluate the safety, tolerability and pharmacokinetics of single and multiple ascending doses of LTP001 in healthy adult participants (Part A) and to evaluate the efficacy and safety of LTP001 for the treatment of participants with pulmonary arterial hypertension (Part B)
Protocol code: CLTP001A12202
Sponsor: Novartis Pharma AG (Pharmaceutical company). Phase: Phase I and Phase II (Integrated)- Other. Countries: Portugal (ongoing, recruiting), Latvia (ongoing, recruiting), Czechia (ongoing, recruiting), Italy (ongoing, recruiting), Belgium (ongoing, recruiting), Germany (ongoing, recruiting), France (ongoing, recruiting), Romania (ongoing, recruiting), Spain (ongoing, recruiting), Poland (ongoing, recruiting), Greece (ongoing, recruiting).
Therapeutic area(s): Diseases [C] - Respiratory Tract Diseases [C08]
Gender: Female, Male. Age: 18-64 years, 65+ years. Enrolment: 82.
Status: Ongoing, recruiting. Start date (EU): 2025-09-18. Decision date: 2025-08-25. Results received: No. Last updated: 2026-07-20.
Decision dates by country: FR: 2025-11-26, GR: 2025-08-26, IT: 2025-08-25, LV: 2025-08-26, BE: 2025-08-27, PL: 2025-09-01, CZ: 2025-08-26, RO: 2025-08-27, ES: 2025-08-26, PT: 2025-08-22, DE: 2025-08-26

Condition(s): Part A: Healthy volunteers (Part A is not applicable to the EU; for information only); Part B: pulmonary arterial hypertension
Product: Placebo to LTP001 00mg hard gelatin capsule, Placebo to LTP001 00mg hard gelatin capsule, LTP001, LTP001

Primary endpoint: Part A: All safety endpoints, including vital signs, ECG, central lab evaluations and AEs up to and including the EoS visit. Part B: (Period 1) Change in PVR from baseline to 24 weeks (Period 2): All safety endpoints, including vital signs, ECG, central lab evaluations, treatment-emergent AEs and discontinuations due to AEs.
Endpoint(s): Part A: Cmax, Tmax, AUClast, AUCinf and T1/2 of LTP001 Part B: (Period 1) Change in 6MWD from baseline to 24 weeks. (Period 2) Change in 6MWD from baseline to 18 months, Part B Period 2: Number of participants experiencing an improvement in WHO FC from baseline to 18 months, Part B (Period 1): Change in WHO FC from baseline to 24 weeks, Part B (Period 1): All safety endpoints, including vital signs, ECG, clinical laboratory evaluations, treatment-emergent adverse events and discontinuations due to adverse events

Source: https://euclinicaltrials.eu/ctis-public/view/2024-513613-12-00